EU clinical trial 2024-518627-29-00: A Phase 2, Randomized, Open-Label, Controlled Study to Evaluate the Efficacy and Safety of Ampligen® Compared to Control Group / No Treatment Following FOLFIRINOX in Subjects with Locally Advanced Pancreatic Adenocarcinoma
Sponsor: Aim Immunotech Inc. (Pharmaceutical company). Phase: Therapeutic exploratory (Phase II). Countries: Netherlands (authorised, recruitment pending).
Therapeutic area(s): Diseases [C] - Neoplasms [C04]
Gender: Female, Male. Age: 18-64 years, 65+ years. Enrolment: 30.
Status: Authorised, recruitment pending. Decision date: 2024-12-05. Results received: No. Last updated: 2024-12-05.

Condition(s): locally advanced pancreatic cancer
Product: Ampligen

Primary endpoint: Progression Free Survival (PFS) [Time Frame: Visit 2/ First Treatment until disease progression, death, or end of study up to 42 months] PFS is defined as the time, in months, from date of Visit 2/ First Treatment to date of the first documentation of definitive disease progression as per RECIST v1.1 (the initial progressive disease (PD)) or death due to any cause.

Source: https://euclinicaltrials.eu/ctis-public/view/2024-518627-29-00